EU clinical trial 2024-512163-31-00: ION363-CS1: A Phase 1-3 Study to Evaluate the Efficacy, Safety, Pharmacokinetics and Pharmacodynamics of Intrathecally Administered ION363 in Amyotrophic Lateral Sclerosis Patients with Fused in Sarcoma Mutations (FUS-ALS)
Protocol code: ION363-CS1
Sponsor: Ionis Pharmaceuticals Inc. (Pharmaceutical company). Phase: Phase II and Phase III (Integrated). Countries: Sweden (ongoing, recruitment ended), Spain (ongoing, recruitment ended), Belgium (ongoing, recruitment ended), Italy (ongoing, recruitment ended), Ireland (ongoing, recruitment ended), Netherlands (ongoing, recruitment ended), Germany (ongoing, recruitment ended), Poland (ended).
Therapeutic area(s): Diseases [C] - Nervous System Diseases [C10]
Gender: Female, Male. Age: 0-17 years, 18-64 years, 65+ years. Enrolment: 57.
Start date (EU): 2022-01-26. Decision date: 2024-08-16. Results received: No. Last updated: 2026-06-02.
Decision dates by country: PL: 2024-10-01, DE: 2024-08-21, NL: 2024-08-19, BE: 2024-08-20, IT: 2024-09-16, SE: 2024-08-16, IE: 2024-08-16, ES: 2024-08-16

Condition(s): Amyotrophic Lateral Sclerosis with Fused in Sarcoma mutations
Product: Artificial Cerebrospinal Fluid (aCSF) for Injection, 5.0 mL (Placebo), ION363, ION363

Primary endpoint: Pr.EndPoint 1: Evaluate the effects of ION363 vs. placebo on change from Baseline to Study Day 505 in Part 1 Cohorts A and B—on functional impairment, measured by joint rank analysis of the combined assessment of the following - In-clinic ALSFRS-R Total Score; ALSFRS-R measures functional disease severity.The scale measures four functional domains, bulbar function, gross motor skills, fine motor skills, and respiratory., Pr.EndPoint 1 (continuation): The assessment will contain 12 questions scored from 0 (no function) to 4 (full function), with a total possible score of 48, which will indicate the highest level of function. ALSFRS-R will be a part of the combined assessment of joint rank analysis to assess efficacy in Part 1., Pr.EndPoint 2: time of rescue (Rescue takes place if there is a deterioration to an ALSFRS_R total score of < 15 points AND a decrease of ≥10 points from baseline at Study Day 253, or later, that is confirmed after an interval of at least 4 weeks. Rescue means the patient may discontinue Part 1 and enter Part 2 of the study);, Pr.EndPoint 3: Ventilation Assistance-free survival (VAFS) defined as the time to the earliest occurrence of one of the following events: a. Death b. Permanent ventilation (> 22 hours of mechanical ventilation [invasive or noninvasive] per day for > 21 consecutive days in the absence of an acute reversible event)
Endpoint(s): Evaluate the effects of ION363 vs. placebo on change (or geometric mean ratio, as appropriate) from Baseline to Study Day 505 in Part 1 Cohorts A and B—on clinical assessments and biomarkers of disease severity, specifically the following endpoints: • Geometric mean ratio from Baseline in serum neurofilament light chain (NfL), Time to earliest of death, permanent ventilation, rescue, or withdrawal due to disease progression, • Change from Baseline in the in-clinic SVC, • Change from Baseline in handheld dynamometry (HHD), • Change from Baseline in the in-clinic ALSFRS-R, • VAFS (i.e., time to earliest of death or permanent ventilation), Change from Baseline in ALS Assessment Questionnaire, 5-item (ALSAQ-5), • Geometric mean ratio from Baseline in CSF NfL, • Geometric mean ratio from Baseline in CSF FUS protein

Source: https://euclinicaltrials.eu/ctis-public/view/2024-512163-31-00